EU clinical trial 2023-504910-31-00: A Randomized, Open-label, Phase 3 Study of MK-2870 vs. Platinum Doublets in Participants With EGFR-mutated, Advanced Non-squamous Non-small Cell Lung Cancer (NSCLC) Who Have Progressed on Prior EGFR Tyrosine Kinase Inhibitors
Protocol code: MK-2870-009
Sponsor: Merck Sharp & Dohme LLC (Pharmaceutical company). Phase: Therapeutic confirmatory (Phase III). Countries: France (ongoing, recruitment ended), Sweden (ongoing, recruitment ended), Italy (ongoing, recruitment ended), Spain (ongoing, recruitment ended), Poland (ongoing, recruitment ended).
Therapeutic area(s): Diseases [C] - Neoplasms [C04]
Gender: Female, Male. Age: 18-64 years, 65+ years. Enrolment: 128.
Status: Ongoing, recruitment ended. Start date (EU): 2024-07-15. Decision date: 2024-06-24. Results received: No. Last updated: 2026-06-30.
Decision dates by country: ES: 2024-06-28, PL: 2024-07-01, FR: 2024-06-28, SE: 2024-06-27, IT: 2024-06-24

Condition(s): Non-small Cell Lung Cancer (NSCLC)
Product: MK-2870, PARACETAMOL, MK-2870, PEMETREXED, CARBOPLATIN

Primary endpoint: Overall survival (OS)
Endpoint(s): Objective response rate (ORR), Duration of response (DOR), Change from baseline in European Organization for Research and Treatment of Cancer Quality of Life Questionnaire-Core 30 (EORTC QLQ-C30) global health status (Item 29) and quality of life (Item 30) combined score, Change from baseline in the dyspnea (item 8) score, on the EORTC QLQ-C30, Change from baseline in the cough (item 31) score, on the EORTC Lung-Cancer specific Quality of Life Questionnaire (QLQ-LC13), Change from baseline in the chest pain (item 40) score, on the EORTC QLQ-LC13, Time to deterioration (TTD) in global health status/quality of life (items 29 and 30) score, on the EORTC-QLQ-C30, TTD in the dyspnea (item 8) score, on the EORTC QLQ-C30, TTD in the cough (item 31) score, on the EORTC QLQ-LC13, TTD in the chest pain (item 40) score, on the EORTC QLQ-LC13, Number of participants who experience one or more adverse events (AEs), Number of participants who discontinue study treatment due to an AE, Progression-free survival (PFS)

Source: https://euclinicaltrials.eu/ctis-public/view/2023-504910-31-00